EU clinical trial 2024-517747-31-00: Psilocybin - a strategy of rapid antidepressant response in depression comorbid with cancer,a randomized double-blind study with the possibility of entering open extension
Protocol code: PSIKET_002CZE
Sponsor: Narodni Ustav Dusevniho Zdravi (Hospital/Clinic/Other health care facility). Phase: Therapeutic exploratory (Phase II). Countries: Czechia (ongoing, recruiting).
Therapeutic area(s): Psychiatry and Psychology [F] - Mental Disorders [F03]
Gender: Female, Male. Age: 18-64 years, 65+ years. Enrolment: 60.
Status: Ongoing, recruiting. Start date (EU): 2022-07-22. Decision date: 2024-11-11. Results received: No. Last updated: 2026-06-30.

Condition(s): Depressive disorder comorbid with cancer

Primary endpoint: The effectiveness of psilocybin will be evaluated by comparison with the antidepressant ketamine and midazolam using the MADRS scale. Response and remission will be evaluated. Baseline is defined as the score obtained at Preparation Session 1 (9 - 7 days) prior to study medication administration. Response is defined as ≥ 50% reduction in MADRS total score from baseline, and remission is defined as ≤10 MADRS
Endpoint(s): The rate of onset and duration of substance use will be assessed using the MADRS objective scale and the BECK self-report scale as change scores on day 1, day 4, 1 week (day 7), 4 weeks (day 28), 8 weeks (day 56 ), 16 weeks (day 112) and 24 weeks (day 224) from administration of study medication compared to baseline., The BECK self-rating scale, which is administered before the administration of the study medication at the beginning of the day and after the administration of the study medication at the end of the day, The effect of psilocybin and ketamine on the patient's subjectively perceived quality of life and well-being will be assessed as a change in the score on the FACIT scale and its sub-scales 1 week (day 7), 4 weeks (day 28) and 24 weeks (day 224) from administration of study medication versus baseline., Efficacy will be assessed as change in HAM-A objective scale and STAI self-report scores at day 1, day 4, 1 week (day 7), 4 weeks (day 28), 8 weeks (day 56), 16. weeks (112th day) and 24 weeks (224th day) from administration of study medication compared to baseline., PEQ scale will be assessed 4 weeks (day 28) and 24 weeks (day 224) after administration of the study medication and will be evaluated as a change from baseline. The effect of psilocybin on existential distress including patients' subjective attitude towards life (LAP-R), subjectively perceived hopelessness (HAI) and demoralization (DS) will be assessed as change in scores on the respective scales at 1 week (day 7), 4 weeks (day 28 ) and 24 weeks (day 224) from administration of study medication., This effect will be monitored using a pain visual analogue scale (VAS) at day 1, 1 week (day 7), 4 weeks (day 28) and 24 weeks (day 224) of study medication administration versus baseline., Evaluation of the antidepressant effect of psilocybin and ketamine depending on the intensity of acute psychological effects during a session with the substance. Acute effects will be assessed by the patient at the end of the day after each session with psilocybin, ketamine and midazolam using the subjective 5D-ASCs and MEQ scales, which reflect the main psychological dimensions of intoxication affecting therapeutic antidepressant response., The antidepressant effect will be compared in patients taking standard antidepressants during the clinical trial (AD-plus group) versus a group of patients not taking antidepressants (AD-free). We hypothesize that the clinical effect of psilocybin will be more pronounced in the AD-plus group than in the AD-free group., Evaluation of the antidepressant effect in the open-label part of the study will correspond to the primary (2.2), secondary (2.3) and exploratory (2.3) objectives, with the evaluation not being blinded and only psilocybin and ketamine being compared (midazolam will not be administered)., The quality of the blinding of the study medication in the double-blind part of the study will be monitored using the BQQ Questionnaire. The estimate of administered study medication will be determined independently of the participant, therapist and co-therapist. The questionnaire will be filled in 4 weeks (day 28) from the administration of the study medication, at the end of Integration Session 3 after evaluation by an independent evaluator., Safety will be assessed by changes in vital signs (blood pressure [BP], heart rate [TF]) during drug sessions, the BPRS scale, and suicidal ideation/behavior scores assessed by the C-SSRS, version Since Last Visit (SLV) at the end of the session with the substance, based on monitoring the incidence of adverse events throughout the study and further evaluating the persistent psychotropic effects of psilocybin using the PSQ scale 1 day after administration of the study medication.

Source: https://euclinicaltrials.eu/ctis-public/view/2024-517747-31-00